EU clinical trial 2025-523262-25-00: A study to test how different doses of BI 3814916 are tolerated by healthy people
Protocol code: 1543-0001
Sponsor: Boehringer Ingelheim International GmbH (Pharmaceutical company). Phase: Human Pharmacology (Phase I)- First administration to humans. Countries: Belgium (ongoing, recruiting).
Therapeutic area(s): Not possible to specify
Gender: Female, Male. Age: 18-64 years, 65+ years. Enrolment: 136.
Status: Ongoing, recruiting. Start date (EU): 2026-05-11. Decision date: 2026-03-13. Results received: No. Last updated: 2026-05-11.

Condition(s): healthy volunteer trial

Source: https://euclinicaltrials.eu/ctis-public/view/2025-523262-25-00